EU clinical trial 2025-522437-65-00: A single-arm phase II-study to confirm efficacy and feasibility of tarlatamab treatment in patients with extensive stage small-cell lung cancer with poor performance status (SPACE-T) [without IMPD-Q]
Protocol code: AIO-TRK-0624
Sponsor: AIO-Studien gGmbH (Laboratory/Research/Testing facility). Phase: Therapeutic exploratory (Phase II). Countries: Germany (authorised, recruiting).
Therapeutic area(s): Diseases [C] - Neoplasms [C04]; Diseases [C] - Respiratory Tract Diseases [C08]
Gender: Female, Male. Age: 18-64 years, 65+ years. Enrolment: 57.
Status: Authorised, recruiting. Start date (EU): 2026-03-06. Decision date: 2025-10-31. Results received: No. Last updated: 2026-04-13.

Condition(s): small-cell lung cancer
Product: Tarlatamab

Primary endpoint: Overall survival (OS) rate at 12 months
Endpoint(s): Overall survival (OS), Progression-free survival (PFS), Objective response rate (ORR) (RECIST v1.1), intracranial ORR (RECIST v1.1), Rate of patients tolerating tarlatamab until first disease assessment, Time to next-line systemic therapy, Safety and tolerability, Quality of life: o EORTC-QLQ-C30 o PRO CTCAE

Source: https://euclinicaltrials.eu/ctis-public/view/2025-522437-65-00